EU clinical trial 2024-516805-22-00: A Phase III Long-Term Extension Trial with Optional Additional Doses of CYB003 to Assess the Safety and Long-term Efficacy in Participants with Major Depressive Disorder (EXTEND)
Protocol code: CYB003-004
Sponsor: Cybin IRL Limited (Pharmaceutical company). Phase: Therapeutic confirmatory (Phase III). Countries: Greece (ongoing, recruiting), Poland (ongoing, recruiting), Ireland (authorised, recruitment pending), Germany (authorised, recruitment pending), Czechia (authorised, recruitment pending).
Therapeutic area(s): Psychiatry and Psychology [F] - Mental Disorders [F03]
Gender: Female, Male. Age: 18-64 years, 65+ years. Enrolment: 131.
Start date (EU): 2026-06-30. Decision date: 2025-09-02. Results received: No. Last updated: 2026-02-23.
Decision dates by country: IE: 2025-09-05, GR: 2025-09-02, DE: 2026-01-09, CZ: 2026-02-23, PL: 2025-09-08

Condition(s): Major Depressive Disorder
Product: CYB003

Primary endpoint: Time to first relapse from Baseline of EXTEND trial in participants who have had a stable response in either the APPROACH or EMBRACE trial
Endpoint(s): Percentage of participants who are either responders or non-responders in APPROACH or EMBRACE and require 2 additional doses of IP in EXTEND., Percentage of participants who are either responders or non-responders in APPROACH or EMBRACE and require 3 additional doses of IP in EXTEND., Percentage of participants with sustained response defined as absence of a relapse after administration of 2 doses of IP in APPROACH or EMBRACE to the endpoint of EXTEND with 1 increase in MADRS total score above 50% decrease in MADRS total score permitted., Percentage of participants with sustained remission defined as MADRS total score ≤10 after administration of 2 doses of IP in APPROACH or EMBRACE to the endpoint of EXTEND with 1 increase in MADRS total score >10 permitted., Percentage of responders and remitters to 2 doses of IP administered in EXTEND who later relapse., Change from Baseline to last visit in the total MADRS score in participants who did not respond to IP in APPROACH or EMBRACE

Source: https://euclinicaltrials.eu/ctis-public/view/2024-516805-22-00